EU clinical trial 2025-525105-20-00: A Phase 1/2, Open-Label, Platform Study to Evaluate Safety and Efficacy of the BCL-2 Inhibitor Surzetoclax (ABBV-453) given as Monotherapy or in Combination with Antimyeloma Regimens in Subjects with Multiple Myeloma
Protocol code: M25-275 - Substudy 3
Sponsor: AbbVie Deutschland GmbH & Co. KG (Pharmaceutical company). Phase: Phase I and Phase II (Integrated)- Other. Countries: Germany (authorised, recruitment pending), Poland (authorised, recruitment pending), Czechia (authorised, recruitment pending), Belgium (authorised, recruitment pending), France (authorised, recruitment pending), Greece (authorised, recruitment pending), Sweden (authorised, recruitment pending), Portugal (authorised, recruitment pending), Italy (authorised, recruitment pending).
Therapeutic area(s): Diseases [C] - Neoplasms [C04]
Gender: Female, Male. Age: 18-64 years, 65+ years. Enrolment: 88.
Status: Authorised, recruitment pending. Decision date: 2026-07-13. Results received: No. Last updated: 2026-07-15.
Decision dates by country: SE: 2026-07-13, PT: 2026-07-14, FR: 2026-07-15, BE: 2026-07-13, PL: 2026-07-14, IT: 2026-07-14, DE: 2026-07-14, CZ: 2026-07-14, GR: 2026-07-14

Condition(s): Multiple Myeloma (MM), Multiple Myeloma (MM)
Product: Surzetoclax, Etentamig, Surzetoclax

Primary endpoint: Dose Limiting Toxicities (DLT) of surzetoclax and etentamig in combination in biomarker-selected subjects with R/R MM.
Endpoint(s): Overall Response Rate (ORR), Progression-Free Survival (PFS), Duration of Response (DOR), Time-to-Progression (TTP), Time to Next Treatment, Rate of minimal residual disease (MRD) Negativity Determined Centrally, using Adaptive's clonoSEQ NGS assay, Overall survival (OS), Pharmacokinetics (PK): Cmax, Tmax, t ½ , AUC.

Source: https://euclinicaltrials.eu/ctis-public/view/2025-525105-20-00